EU clinical trial 2022-501941-63-00: A study to investigate the safety and clinical activity of belantamab for the treatment of multiple myeloma when used as monotherapy and in combination treatments.
Protocol code: 218670
Sponsor: Glaxosmithkline Research & Development Limited (Pharmaceutical company). Phase: Phase I and Phase II (Integrated)- First administration to humans. Countries: Poland (ongoing, recruiting), Finland (authorised, recruitment pending), Germany (authorised, recruitment pending), Italy (authorised, recruitment pending), Sweden (authorised, recruitment pending), Greece (authorised, recruitment pending).
Therapeutic area(s): Diseases [C] - Neoplasms [C04]
Gender: Female, Male. Age: 18-64 years, 65+ years. Enrolment: 32.
Start date (EU): 2023-12-13. Decision date: 2023-05-08. Results received: No. Last updated: 2026-04-28.
Decision dates by country: PL: 2023-05-08, DE: 2026-04-14, IT: 2026-04-22, SE: 2026-03-31, GR: 2026-04-08, FI: 2026-04-28

Condition(s): Multiple myeloma

Source: https://euclinicaltrials.eu/ctis-public/view/2022-501941-63-00